EU clinical trial 2023-504421-39-00: A 6-Month Phase 3, Multicenter, Prospective, Randomized, Double-Blind, Vehicle-Controlled Study, to Evaluate the Efficacy and Safety of Topically Applied Clascoterone (Cortexolone 17α-Propionate) Solution for the Treatment of Androgenetic Alopecia in Males, Followed by a 6-Month Single-Blind Treatment with Clascoterone or Vehicle BID Solution (SCALP 2)
Protocol code: CB-03-01/38
Sponsor: Cassiopea S.p.A. (Pharmaceutical company). Phase: Therapeutic confirmatory (Phase III). Countries: Germany (ended), Poland (ended).
Therapeutic area(s): Diseases [C] - Skin and Connective Tissue Diseases [C17]
Gender: Male. Age: 18-64 years, 65+ years. Enrolment: 629.
Status: Ended. Start date (EU): 2023-11-21. End date (EU): 2025-07-16. End date: 2025-07-17. Decision date: 2023-10-30. Results received: No. Last updated: 2025-08-19.
Decision dates by country: DE: 2023-10-30, PL: 2023-11-03

Condition(s): Androgenetic Alopecia
Product: Clascoterone Solution, Vehicle solution

Primary endpoint: Co-Primary Efficacy Endpoints: Changes from Pivotal Part 1 Baseline in non-vellus TAHC at Month 6. / Subject’s assessment of own hair coverage at Month 6, defined as the proportion of MAA-PRO core measure item 2 responder at Month 6.
Endpoint(s): 1) Changes from Pivotal Part 1 Baseline in non-vellus TAHC at Month 3. 2) Changes in MAA-PRO SI single treatment satisfaction item (item 15) score at Month 6.

Source: https://euclinicaltrials.eu/ctis-public/view/2023-504421-39-00